EU clinical trial 2023-508621-27-00: A Single Dose, Fed state, Crossover Replicate, Bioequivalence Study of Naproxen 500 mg/ Esomeprazole 20 mg modified-release tablets (Antibiotice S.A.) versus Vimovo® 500 mg/20 mg film coated tablets (Grunenthal GmbH)
Protocol code: NAESAIS 02/2023
Sponsor: Antibiotice S.A. (Pharmaceutical company). Phase: Human Pharmacology (Phase I)- Bioequivalence Study. Countries: Romania (ended).
Therapeutic area(s): Phenomena and Processes [G] - Musculoskeletal and Neural Physiological Phenomena [G11]; Diseases [C] - Musculoskeletal Diseases [C05]
Gender: Female, Male. Age: 18-64 years. Enrolment: 32.
Status: Ended. Start date (EU): 2024-03-05. End date (EU): 2024-04-30. Decision date: 2024-03-04. Results received: No. Last updated: 2024-03-04.

Condition(s): healthy subjects

Source: https://euclinicaltrials.eu/ctis-public/view/2023-508621-27-00